EU clinical trial 2024-517439-39-00: SAFETY AND PHARMACOKINETICS OF ODM-208 IN PATIENTS WITH METASTATIC CASTRATION-RESISTANT PROSTATE CANCER
Protocol code: 3124001
Sponsor: Orion Corporation (Pharmaceutical company). Phase: Phase I and Phase II (Integrated)- First administration to humans. Countries: France (ended), Finland (ended).
Therapeutic area(s): Diseases [C] - Neoplasms [C04]
Gender: Male. Age: 18-64 years, 65+ years. Enrolment: 129.
Status: Ended. Start date (EU): 2018-03-19. End date (EU): 2026-04-28. Decision date: 2024-10-29. Results received: No. Last updated: 2026-06-16.
Decision dates by country: FI: 2024-10-29, FR: 2024-11-07

Condition(s): Metastatic castration-resistant prostate cancer.
Product: ODM-208 100 mg Tablet, ODM-208 5 mg film-coated tablet, ODM-208 50 mg Tablet, ODM-208 25 mg Tablet, MIDAZOLAM

Primary endpoint: - Safety: adverse events, vital signs including blood pressure, heart rate, body temperature and orthostatic test (part 1 only), 12-lead ECGs; physical exams, laboratory assessments: hematology, chemistry, urinalysis. Determined at several time-points - MTD/DLTs - Efficacy assessments: Serum total PSA, soft tissue response by CT or MRI scan, bone scan, ECOG performance score. Circulating tumour cell (CTC) response (Part 2 only)
Endpoint(s): - Pharmacokinetic assessments: Multiple blood samples for PK; Plasma samples for protein binding - Metabolite screening: Multiple blood samples and urine collection - Recommended dose for further studies. - evaluate different AR LBD activating mutations and their association with antitumour activity of ODM-208., Exploratory: - Pharmacodynamic assessments: Testosterone level and other steroid hormones; - Biomarker assessments: Biomarkers in plasma may be performed on the steroid hormone samples; Germline DNA and pharmacogenomics. - to evaluate the relationship between AR-V7 splicing variant and antitumor activity of ODM-208 (Part 2/Phase 2 only), Exploratory: - molecular biomarkers at genomic, protein and metabolite level from plasma/serum - overall survival assessment (Part 2/Phase 2 only)

Source: https://euclinicaltrials.eu/ctis-public/view/2024-517439-39-00